EU clinical trial 2022-501335-16-00: EvER-ILD 2: Evaluation of Efficacy and safety of Rituximab in patients with progressive Interstitial Lung Disease (ILD) with inflammatory component: a multicentre double-blind placebo-controlled randomized trial
Protocol code: DR210299
Sponsor: Centre Hospitalier Regional Universitaire De Tours (Hospital/Clinic/Other health care facility). Phase: Phase II and Phase III (Integrated). Countries: France (ongoing, recruiting).
Therapeutic area(s): Diseases [C] - Respiratory Tract Diseases [C08]
Gender: Female, Male. Age: 18-64 years, 65+ years. Enrolment: 126.
Status: Ongoing, recruiting. Start date (EU): 2023-01-16. Decision date: 2022-10-10. Results received: No. Last updated: 2025-10-08.

Condition(s): Interstitial lung disease
Product: SODIUM CHLORIDE, RITUXIMAB

Primary endpoint: The primary outcome is the change in Forced Vital Capacity (FVC) (in mL) from baseline to 6 months.
Endpoint(s): Change from baseline in FVC (in % of predicted) to 6 months, Progression free survival (PFS) at 6 months, defined as the time to (first event considered): a) a first acute exacerbation, or b) a relative decline in the FVC of ≥ 10% of the predicted value, or c) the need for new immunosuppressive therapy or/and anti-fibrotic therapies (excluding corticosteroids), or d) inclusion on a lung transplant list, or e) death., Changes from baseline to 6 months in the King’s Brief Interstitial Lung Disease (K-BILD) questionnaire and L-PF symptom and impact questionnaire, Difference in cumulative doses of corticosteroids at 6 months, Changes from baseline to 6 months in % of predicted diffusing capacity for carbon monoxide (DLCO), Changes from baseline to 6 months in the 6-minute walk test, Change from baseline to 6 months in accelerometer-assessed physical activity, Changes from baseline to 6 months of biological markers related to B-cell depletion: CD19 lymphocytes and gammaglobulins,, Changes from baseline to 6 months of serology by ELISA of 15 environmental antigens., Changes from baseline to 6 months in high-resolution computed tomography (HRCT) of chest images, All adverse events, especially serious infectious adverse events, occurring during the six-month treatment period, Pharmacokinetic parameters of rituximab: volume of distribution, rituximab clearance and half-life, Change from baseline to 6 months of SARS COV 2 antibodies

Source: https://euclinicaltrials.eu/ctis-public/view/2022-501335-16-00